EU clinical trial 2024-513707-14-00: MOIO_Randomized phase III trial of standard immunotherapy (IO) by checkpoint inhibitors, versus reduced dose intensity of IO in patients with locally advanced or metastatic cancer in response after 6 months of standard IO
Protocol code: UC-IMM-2101
Sponsor: Unicancer (Hospital/Clinic/Other health care facility). Phase: Therapeutic confirmatory (Phase III). Countries: France (ongoing, recruitment ended).
Therapeutic area(s): Diseases [C] - Neoplasms [C04]
Gender: Female, Male. Age: 18-64 years, 65+ years. Enrolment: 646.
Status: Ongoing, recruitment ended. Start date (EU): 2022-01-14. Decision date: 2024-07-29. Results received: No. Last updated: 2026-03-06.

Condition(s): Only patients with oncologic locally advanced or metastatic tumour (lung cancer, renal cell cancer (except IMDC favorable-risk treated Tyrosine Kinase Inhibitor [TKI] / immunotherapy [IO] combination), head and neck cancer, urothelial carcinoma, triple negative breast cancer, Merkel cancer, melanoma, hepatocellular carcinoma, colorectal carcinoma with microsatellite instability [MSI], esophageal squamous cell carcinoma, endometrial carcinoma, or cervical cancer, gastric/gastro-esophageal junction/esophageal adenocarcinoma, basal cell carcinoma or squamous skin carcinoma) in partial or complete response (except for melanoma, only patients in partial response) after 6 months of standard IO treatment (monotherapy or previously in combination with other immunotherapy (ipilimumab) or chemotherapy or continuous combination with pemetrexed or bevacizumab or TKI).
Product: AVELUMAB, DOSTARLIMAB, ATEZOLIZUMAB, AVELUMAB, CEMIPLIMAB, DOSTARLIMAB, NIVOLUMAB, PEMBROLIZUMAB, NIVOLUMAB, DURVALUMAB, CEMIPLIMAB, ATEZOLIZUMAB, PEMBROLIZUMAB, DURVALUMAB

Primary endpoint: Progression-free survival (PFS) is calculated from the date of randomization to the date of first progression or death from any cause, whichever occurs first. Progression will be determined locally by the investigator through the use of RECIST v1.1 in case of lesions identified at baseline (for patients assessed by PET-scan, progression will be determined according to PERCIST criteria v1.0).
Endpoint(s): Incremental cost-effectiveness ratio (ICER) expressed as a cost per quality-adjusted life year (QALY) gained at 36 months, Immune progression-free survival (iPFS) calculated from the date of randomization to the date of disease progression criteria (iPD) or death from to any cause, whichever occurs first. Immune progression (iPD) will be determined locally by the investigator through the use of iRECIST or imPERCIST criteria in case of lesions identified at baseline., Objective response rate (ORR) defined as the percentage of patients with a confirmed complete response (CR) or partial response (PR) as assessed by the investigator using RECIST v1.1 or PERCIST v1.0 criteria at 12 and 24 months post-randomization considering patients who switch from study treatment to any other cancer treatment within 12 and 24 months post-randomization as failures., Overall survival calculated from the date of randomization to the date of death from any cause, Duration of response (DoR) defined as the time from randomization to first documented response until progression disease progression or death, whichever occurs first, Quality of life mean score of self-reported EORTC QLQ-C30, and the EQ-5D-5L questionnaires at inclusion visit (pre-randomization), 3, 6, 9, 12, 15, 18, 24 and 36 months post-randomization., Evaluation of anxiety and fear of relapse using specific questionnaires at 3, 6, 9, 12, 15, 18, 24 and 36 months post-randomization., Number, frequency and severity of adverse events according to CTCAE v5.0 at 12 months and 3 years post-randomization., Pharmacokinetic study: Comparison of IO’s residual concentrations in plasma between treatment arms., Immune monitoring: Comparison of soluble forms of immune checkpoints in plasma and immune cells population in PBMC between treatment arms., Circulating tumour DNA study: Circulating tumor load and tumor mutation burden (TMB) will be explored using panel-based NGS on plasma samples collected at inclusion and also at progression when available in each treatment arm. The prognostic impact of specific mutation signatures will also be explored

Source: https://euclinicaltrials.eu/ctis-public/view/2024-513707-14-00